EU clinical trial 2024-516961-35-01: MENPI: Safety and immunogenicity following meningococcal and pneumococcal immunization among adult people living with HIV. A single center, non-blinded, randomized clinical trial
Sponsor: Hvidovre Hospital (Hospital/Clinic/Other health care facility). Phase: Phase III and phase IV (Integrated). Countries: Denmark (authorised, recruitment pending).
Therapeutic area(s): Diseases [C] - Bacterial Infections and Mycoses [C01]
Gender: Female, Male. Age: 18-64 years, 65+ years. Enrolment: 55.
Status: Authorised, recruitment pending. Decision date: 2024-10-11. Results received: No. Last updated: 2024-10-11.

Condition(s): HIV

Source: https://euclinicaltrials.eu/ctis-public/view/2024-516961-35-01